EU clinical trial 2025-521286-27-00: INCA000585-201 - A PHASE 2A, OPEN-LABEL, MULTI-CENTER STUDY OF TAFASITAMAB IN ADULT PARTICIPANTS WITH AUTOIMMUNE BLOOD CELL DISORDERS
Protocol code: INCA000585-201
Sponsor: Incyte Corp. (Pharmaceutical company). Phase: Phase II and Phase III (Integrated). Countries: Netherlands (ongoing, recruiting), Italy (ongoing, recruiting), Spain (ongoing, recruiting), France (ongoing, recruiting).
Therapeutic area(s): Diseases [C] - Hemic and Lymphatic Diseases [C15]
Gender: Female, Male. Age: 18-64 years, 65+ years. Enrolment: 20.
Status: Ongoing, recruiting. Start date (EU): 2026-04-08. Decision date: 2026-02-23. Results received: No. Last updated: 2026-06-30.
Decision dates by country: IT: 2026-02-24, ES: 2026-02-25, NL: 2026-02-24, FR: 2026-02-23

Condition(s): Immune-mediated thrombocytopenia, Autoimmune thrombocytopenia, Autoimmune hemolytic anemia
Product: MINJUVI 200 mg powder for concentrate for solution for infusion

Primary endpoint: AEs, assessed by changes in vital signs, through clinical laboratory blood sample evaluations, ECGs, ECOG performance status, and treatment interruptions or discontinuations., Stable platelet response, defined as platelet count ≥ 50 × 10⁹/L in the absence of clinically significant bleeding or rescue therapy at ≥ 2 consecutive assessments any time after Day 56 until Week 48., Stable hemoglobin response, defined as hemoglobin ≥ 10 g/dL and a ≥ 2 g/dL increase from baseline in the absence of rescue therapy at ≥ 2 consecutive assessments any time after Day 56 until Week 48.
Endpoint(s): CR at Week 24, defined as platelet count ≥ 100 × 10⁹/L at Week 24 in the absence of clinically significant bleeding or rescue therapy., CR at Week 48 (complete remission), defined as platelet count ≥ 100 × 10 9 /L at Week 48 in the absence of clinically significant bleeding or rescue therapy., PR at Week 24, defined as platelet count ≥ 30 × 10 9/L and at least a 2-fold increase of baseline platelet count at Week 24 in the absence of clinically significant bleeding or rescue therapy., Duration of stable platelet response, defined as time from start of stable platelet response to loss of platelet response (< 50 × 10⁹/L), clinically significant bleeding, need for rescue therapy, or death, whichever occurs first., Duration of CR, defined as time from the start of CR to loss of CR (platelet count < 100 × 10⁹/L), clinically significant bleeding, need for rescue therapy, or death, whichever occurs first., Duration of response, defined as time from the date of the first response (PR or CR) to the loss of response (platelet count < 30 × 10⁹/L or a less than a 2-fold increase of baseline platelet count), clinically significant bleeding, need for rescue therapy, or death, whichever occurs first., CR at Week 24, defined as hemoglobin ≥ 12 g/dL and normalization of hemolytic markers (unconjugated bilirubin, LDH, haptoglobin, and reticulocytes) at Week 24 in the absence of rescue therapy., CR at Week 48 (complete remission), defined as hemoglobin ≥ 12 g/dL and normalization of hemolytic markers (unconjugated bilirubin, LDH, haptoglobin, and reticulocytes) at Week 48 in the absence of rescue therapy., PR at Week 24, defined as hemoglobin ≥ 10 g/dL and a ≥ 2 g/dL increase from baseline at Week 24 in the absence of rescue therapy., Duration of stable hemoglobin response, defined as time from start of stable hemoglobin response to loss of stable hemoglobin response (< 10 g/dL or a < 2 g/dL increase from baseline), need for rescue therapy, or death, whichever occurs first., Duration of CR, defined as time from start of CR to loss of CR (hemoglobin < 12 g/dL or abnormal hemolytic markers [unconjugated bilirubin, LDH, haptoglobin, and reticulocytes]), need for rescue therapy, or death, whichever occurs first., Duration of response, defined as time from the date of the first response (PR or CR) to the loss of response (hemoglobin < 10 g/dL), need for rescue therapy, or death, whichever occurs first., Change from baseline in serum antidrug antibody levels.

Source: https://euclinicaltrials.eu/ctis-public/view/2025-521286-27-00